EU clinical trial 2024-513918-35-00: Study of JNJ-74856665 in patients with Acute Myeloid Leukemia or Myelodysplastic Syndrome
Protocol code: 74856665AML1001
Sponsor: Janssen Cilag International (Pharmaceutical company). Phase: Human Pharmacology (Phase I)- First administration to humans. Countries: Spain (ended).
Therapeutic area(s): Diseases [C] - Neoplasms [C04]
Gender: Female, Male. Age: 18-64 years, 65+ years. Enrolment: 1.
Status: Ended. Start date (EU): 2020-12-22. End date (EU): 2025-08-25. Decision date: 2024-07-26. Results received: No. Last updated: 2024-07-26.

Condition(s): Acute myeloid leukemia or Myelodysplastic syndrome

Source: https://euclinicaltrials.eu/ctis-public/view/2024-513918-35-00